EU clinical trial 2023-504034-22-00: A Prospective, Open-Label, Multicenter Randomized Phase III Trial to Compare the Efficacy and Safety of a Combined Regimen of Obinutuzumab and Venetoclax (GDC-0199/ABT-199) Versus Obinutuzumab and Chlorambucil in Previously Untreated Patients with CLL and Coexisting Medical Conditions
Protocol code: BO25323
Sponsor: F. Hoffmann-La Roche AG (Pharmaceutical company). Phase: Therapeutic confirmatory (Phase III). Countries: Bulgaria (ended), Estonia (ended), Romania (ended), France (ended), Spain (ended), Denmark (ended), Croatia (ended), Germany (ended), Austria (ended), Italy (ended), Poland (ended).
Therapeutic area(s): Diseases [C] - Hemic and Lymphatic Diseases [C15]
Gender: Female, Male. Age: 18-64 years, 65+ years. Enrolment: 267.
Status: Ended. Start date (EU): 2014-12-18. End date (EU): 2025-08-06. End date: 2025-08-29. Decision date: 2023-11-30. Results received: No. Last updated: 2025-06-27.
Decision dates by country: AT: 2023-12-15, BG: 2023-11-30, HR: 2023-12-14, EE: 2023-12-04, FR: 2023-12-04, RO: 2023-12-05, PL: 2024-05-21, DE: 2023-12-11, IT: 2024-01-12, ES: 2023-12-01, DK: 2023-12-01

Condition(s): Chronic Lymphocytic Leukemia (CLL)
Product: Gazyvaro 1,000 mg concentrate for solution for infusion., Chlorambucil 2 mg tablets, Fasturtec 1.5 mg/ml powder and solvent for concentrate for solution for infusion., Venclexta, Venclyxto, Venclexta, Venclyxto, Venclexta, Venclyxto

Primary endpoint: Progression-free survival (PFS), defined as the time from randomization to the first occurrence of progression, relapse or death from any cause as assessed by the investigator using IWCLL criteria
Endpoint(s): 1. PFS based on IRC-assessments, defined as the time from randomization to the first occurrence of progression or relapse or death from any cause, 2. Objective response rate ([ORR] defined as rate of a clinical response of complete response [CR], CR with incomplete bone marrow recovery [CRi] or partial response [PR]) as determined by the investigator, according to the IWCLL criteria, 3. Complete response rate (defined as rate of a clinical response of CR or CRi) at the completion of treatment assessment, as determined by the investigator according to the IWCLL guidelines), 4. Minimal residual disease (MRD) response rate (determined as the proportion of patients with MRD-negativity) measured in the peripheral blood at the completion of treatment assessment and also MRD response rate as measured in the bone marrow at the completion of treatment, both measured by ASO-PCR, 5. Overall survival (OS), defined as the time between the date of randomization and the date of death due to any cause. Patients who were not reported as having died at the time of the analysis will be censored at the date when they were last known to be alive, 6. MRD response rates in the peripheral blood at completion of combination treatment assessment (Cycle 9, Day 1 or 3 months after last IV infusion) and also MRD response rate as measured in the bone marrow, both measured by ASO-PCR, 7. Overall response rate (ORR) at completion of combination treatment response assessment (Cycle 7, Day 1 or 28 days after last IV infusion), 8. Duration of response, defined as the time from the first occurrence of a documented Overall survival (OS) (CR, CRi or PR) to the time of progressive disease (PD) as determined by the investigator, or death from any cause, 9. Best response achieved (CR, CRi, PR, stable disease, or PD) up to and including the assessment at completion of treatment assessment (within 3 months of last day of treatment), 10. Event-free survival (EFS), defined as the time between date of randomization and the date of disease progression/relapse as assessed by the investigator, death, or start of a new anti-leukemic therapy. Patients without an EFS event will be will be censored on the date of the last disease assessment., 11. Time to new anti-leukemic treatment, defined as the time between the date of randomization and the date of first intake of new anti leukemic therapy. Patients who have not taken new anti-leukemic therapy will be censored at their last assessment prior to the analysis or date of death, 12. Incidence of adverse events assessed according to the National Cancer Institute Common Terminology Criteria for Adverse Events (NCI CTCAE) version 4.0, 13. Incidence of severe adverse events, 14. Incidence of adverse events of special interest, 15. To characterize the pharmacokinetics of venetoclax and of obinutuzumab (including population PK [pop-PK] techniques)

Source: https://euclinicaltrials.eu/ctis-public/view/2023-504034-22-00